EU clinical trial 2024-514326-23-00: An Open-Label Extension and long-term efficacy and safety monitoring study of patients with Crohn's disease previously included in the loss of RESponse to Ustekinumab treated by dose Escalation study (REScUE-OLE)
Protocol code: BIRD2020001
Sponsor: Belgian IBD Research and Development (Laboratory/Research/Testing facility). Phase: Phase III and phase IV (Integrated). Countries: Belgium (ended).
Therapeutic area(s): Diseases [C] - Digestive System Diseases [C06]
Gender: Female, Male. Age: 18-64 years, 65+ years. Enrolment: 108.
Status: Ended. Start date (EU): 2021-09-10. End date (EU): 2026-05-29. Decision date: 2024-07-01. Results received: No. Last updated: 2025-09-12.

Condition(s): Crohn's disease
Product: STELARA 90 mg solution for injection in pre-filled syringe

Primary endpoint: Proportion of patients in both treatment arms in steroid-free clinical remission (PRO-2 remission: average AP≤1 and average SF≤3 without any steroid use in the previous 28 days) at both week 56 and week 112 of the study (sustained steroid-free clinical remission).
Endpoint(s): Incidence and severity of adverse events in both treatment arms., Time to CD worsening (as defined in section 3.2.1 of the protocol) in both treatment arms., Proportion of patients in both treatment arms in steroid-free clinical remission (PRO-2 remission: average AP≤1 and average SF≤3 without any steroid use in the previous 28 days) at week 56 of the study., Proportion of patients in both treatment arms in steroid-free clinical remission (PRO-2 remission: average AP≤1 and average SF≤3 without any steroid use in the previous 28 days) at week 112 of the study., Proportion of patients previously enrolled to the ustekinumab 90 mg SC Q8w-arm during REScUE who needed dose optimization to ustekinumab 90 mg SC Q4w at the start or during REScUE-OLE (≤week 100), and that reached steroid-free clinical remission (PRO-2 remission: average AP≤1 and average SF≤3 without any steroid use in the previous 28 days) at week 112., Proportion of patients in both treatment arms in clinical remission (PRO-2 remission: average AP≤1 and average SF≤3) at both week 56 and week 112 of the study (sustained clinical remission)., Proportion of patients in both treatment arms in clinical remission (PRO-2 remission: average AP≤1 and average SF≤3) at week 56 of the study., Proportion of patients in both treatment arms in clinical remission (PRO-2 remission: average AP≤1 and average SF≤3) at week 112 of the study., Proportion of patients previously enrolled to the ustekinumab 90 mg SC Q8w-arm during REScUE who needed dose optimization to ustekinumab 90 mg SC Q4w at the start or during REScUE-OLE (≤week 100), and that reached clinical remission (PRO-2 remission: average AP≤1 and average SF≤3) at week 112., Proportion of patients in both treatment arms with biomarker remission (CRP <5 mg/L and FC≤250 µg/g) at week 56 of the study., Proportion of patients in both treatment arms with biomarker remission (CRP <5 mg/L and FC≤250 µg/g) at week 112 of the study., Proportion of patients previously enrolled to the ustekinumab 90 mg SC Q8w-arm during REScUE who needed dose optimization to ustekinumab 90 mg SC Q4w at the start or during REScUE-OLE (≤week 100), and that reached biomarker remission (CRP<5 mg/L and FC≤250 µg/g) at week 112., Proportion of patients in both treatment arms in endoscopic remission (total SES-CD <5 or for isolated ileitis <4) at week 56 of the study., Proportion of patients in both treatment arms in endoscopic remission (total SES-CD <5 or for isolated ileitis <4) at week 112 of the study., Proportion of patients previously enrolled to the ustekinumab 90 mg SC Q8w-arm during REScUE who needed dose optimization to ustekinumab 90 mg SC Q4w at the start or during REScUE-OLE (≤ week 100), and that reached endoscopic remission (total SES-CD <5 or for isolated ileitis <4) at week 112., Proportion of patients in both treatment arms in complete endoscopic remission (total SES-CD <3) at week 56 of the study., Proportion of patients in both treatment arms in complete endoscopic remission (total SES-CD <3) at week 112 of the study., Proportion of patients previously enrolled to the ustekinumab 90 mg SC Q8w-arm during REScUE who needed dose optimization to ustekinumab 90 mg SC Q4w at the start or during REScUE-OLE (≤ week 100), and that reached complete endoscopic remission (total SES-CD<3) at week 112.

Source: https://euclinicaltrials.eu/ctis-public/view/2024-514326-23-00